EU clinical trial 2025-523735-19-00: A Randomized, Double-Blind, Phase 3 Study of Standard-of-Care Chemotherapy and Bevacizumab With or Without INCA33890 in the First-Line Treatment of Metastatic Microsatellite Stable Colorectal Cancer
Protocol code: INCA033890-303
Sponsor: Incyte Corp. (Pharmaceutical company). Phase: Therapeutic confirmatory (Phase III). Countries: Poland (authorised, recruitment pending), France (ongoing, recruiting), Denmark (authorised, recruitment pending), Norway (authorised, recruitment pending), Spain (authorised, recruitment pending), Germany (authorised, recruitment pending), Belgium (ongoing, recruiting), Netherlands (authorised, recruitment pending), Austria (authorised, recruitment pending), Italy (authorised, recruitment pending).
Therapeutic area(s): Diseases [C] - Neoplasms [C04]
Gender: Female, Male. Age: 18-64 years, 65+ years. Enrolment: 292.
Start date (EU): 2026-07-20. Decision date: 2026-05-19. Results received: No. Last updated: 2026-06-04.
Decision dates by country: AT: 2026-05-25, DK: 2026-05-19, FR: 2026-05-26, DE: 2026-05-20, IT: 2026-05-22, ES: 2026-05-22, NL: 2026-05-26, NO: 2026-05-19, PL: 2026-05-25, BE: 2026-06-04

Condition(s): Metastatic Microsatellite Stable Colorectal Cancer
Product: BEVACIZUMAB, FLUOROURACIL, OXALIPLATIN, INCA33890, Placebo contains the same formulation buffer, 10 mM acetate, 9% (w/v) sucrose and 0.02% (w/v) polysorbate 80, at pH 5.5, without the active pharmaceutical ingredient., CALCIUM FOLINATE

Primary endpoint: PFS, defined as the time from the date of randomization to the date of the first documented progression as determined by BICR (Blinded Independent Central Review) per RECIST v1.1 or death due to any cause.
Endpoint(s): OS, defined as the time from the date of randomization to the date of death due to any cause., Objective response, defined as CR or PR as determined by BICR (Blinded Independent Central Review) per RECIST v1.1., DOR, defined as the time from the earliest date of documented response until the earliest date of disease progression as determined by BICR per RECIST v1.1 or death due to any cause, whichever occurs first., TEAEs per CTCAE v6.0 and TEAEs leading to dose interruption or study drug discontinuation.

Source: https://euclinicaltrials.eu/ctis-public/view/2025-523735-19-00